EU clinical trial 2024-511719-40-00: Efficay and safety of ampicillin and ceftriaxone continuous infusion versus standard therapy for the treatment of Enterococcus faecalis infective endocarditis (DOβLEI Study)
Protocol code: DOβLEI
Sponsor: Fundacion Publica Andaluza Para La Gestion De La Investigacion En Salud De Sevilla (Laboratory/Research/Testing facility). Phase: Therapeutic use (Phase IV). Countries: Spain (ongoing, recruiting).
Therapeutic area(s): Diseases [C] - Skin and Connective Tissue Diseases [C17]; Diseases [C] - Bacterial Infections and Mycoses [C01]
Gender: Female, Male. Age: 18-64 years, 65+ years. Enrolment: 284.
Status: Ongoing, recruiting. Start date (EU): 2024-10-09. Decision date: 2024-07-30. Results received: No. Last updated: 2026-02-17.

Condition(s): Enterococcus faecalis infectious endocarditis
Product: Dalbavancina Sala 500 mg polvo para concentrado para solución para perfusión EFG, Linezolid Teva Pharma 600 mg comprimidos recubiertos con película EFG, Teicoplanina Sala 200 mg polvo para solución inyectable y para perfusión EFG., CEFTRIAXONE, Daptomicina Accord 500 mg polvo para solución inyectable y para perfusión EFG, Moxifloxacino Sandoz 400 mg comprimidos recubiertos con película EFG, Rifaldin 300 mg cápsulas, AMPICILLIN, Linezolid Demo 2 mg/ml solución para perfusión EFG, Amoxicilina Teva 1.000 mg comprimidos EFG

Primary endpoint: Treatment failure defined as confirmed recurrence of infective endocarditis due to Enterococcus faecalis (microbiological failure) one year after completion of antibiotic treatment
Endpoint(s): Treatment failure assessed up to one year after completion of treatment and defined as follows: mortality (therapeutic failure) from any cause during hospitalization or from endocarditis-related causes throughout the study., Number of unplanned cardiac surgeries during the entire study., Number of unplanned readmissions during the entire trial., Number of medication-related adverse events from randomisation until 30 days after the last dose administered., Total number of antibiotic treatment days, number of TADE treatment days in those patients who receive continuous infusion (experimental arm) and their site has a TADE programme, and number of healthcare-associated infections throughout the trial., Confirmed recurrence of Enterococcus faecalis infective endocarditis throughout the study., Minimum free serum concentration and steady-state plasma concentration of ceftriaxone and ampicillin for 24 hours on day 14 after initiation of treatment (visit 2) in the experimental arm., Pharmacokinetic parameters (volume of distribution, clearance, elimination constant) of ceftriaxone and ampicillin on day 14 after initiation of treatment (visit 2)., Synergistic activity will be calculated through the reduction of the Minimum Inhibitory Concentration of ampicillin induced by ceftriaxone in the strains responsible for recurrences and control strains.

Source: https://euclinicaltrials.eu/ctis-public/view/2024-511719-40-00